EU clinical trial 2023-505050-18-00: Tofacitinib in early active axial spondyloarthritis: a prospective, randomized, double-blind, placebo-controlled multicentre study - FASTLANE
Protocol code: FASTLANE2022
Sponsor: Charite Universitaetsmedizin Berlin KöR (Hospital/Clinic/Other health care facility). Phase: Therapeutic use (Phase IV). Countries: Germany (ended), Bulgaria (ended), Poland (ended), Czechia (ended).
Therapeutic area(s): Diseases [C] - Immune System Diseases [C20]; Diseases [C] - Musculoskeletal Diseases [C05]
Gender: Female, Male. Age: 18-64 years. Enrolment: 104.
Status: Ended. Start date (EU): 2023-11-16. End date (EU): 2025-07-04. Decision date: 2023-10-13. Results received: Yes. Last updated: 2025-01-29.
Decision dates by country: BG: 2023-11-08, CZ: 2023-11-08, PL: 2023-11-08, DE: 2023-10-13

Condition(s): Axial spondyloarthritis
Product: XELJANZ 5 mg film-coated tablets, Placebo for Tofacitinib (CP-690,550-10) 5mg film-coated tablets, Naproxen STADA® 500 mg Tabletten

Primary endpoint: Proportion of subjects achieving disease remission defined as Ankylosing Spondylitis Disease Activity Score (ASDAS)CRP<1.3 at week 16 from baseline.
Endpoint(s): Change from baseline in the MRI SIJ SPARCC osteitis score at week 16, Proportion of subjects requiring treatment escalation to open label tofacitinib at week 4, Proportion of subjects achieving ASDASCRP low disease activity (<2.1), ASDASCRP clinically important improvement (≥1.1), ASDASCRP major improvement (≥2.0), ASAS response criteria ASAS20, ASAS40, ASAS partial remission, Bath Ankylosing Spondylitis Disease Activity Index (BASDAI) 50 at weeks 4 and 16, Change from baseline in BASDAI (NRS) and Patient Global Assessment (PtGA; NRS) at weeks 1, 2, 3, 4, 8, 12 and 16, Change from baseline in ASDASCRP, Physician Global Assessment (NRS), and serum C-reactive protein (CRP) at weeks 4 and 16, Change from baseline in total back pain (corresponding to Question 2 of BASDAI; NRS), nocturnal back pain (NRS), total pain in the last 24 hours (NRS), total back pain in the last 24 hours (NRS), and nocturnal back pain in the last 24 hours (NRS) at weeks 1, 2, 3, 4, 8, 12 and 16, Change from baseline in total pain in the last 24 hours (NRS), total back pain in the last 24 hours (NRS), and nocturnal back pain in the last 24 hours (NRS) at days 1 to 6, Change from baseline in Bath Ankylosing Spondylitis Functional Index (BASFI), Bath Ankylosing Spondylitis Metrology Index (BASMI), and chest expansion at weeks 4 and 16, Change from baseline in 44 Swollen Joint Count (44 SJC), 44 Tender Joint Count (44 TJC), Maastricht Ankylosing Spondylitis Enthesitis Score (MASES), and dactylitis count at weeks 4 and 16, Change from baseline in Functional Assessment of Chronic Illness Therapy – Fatigue (FACIT-F) and ASAS Health Index at weeks 4 and 16, Proportion of subjects with anterior uveitis, inflammatory bowel disease or psoriasis from baseline to week 16., Incidence rate of adverse events (AEs), treatment-emergent AEs, AEs of special interest, serious AEs, and AEs leading to study discontinuation by week 20

Source: https://euclinicaltrials.eu/ctis-public/view/2023-505050-18-00